EU clinical trial 2023-504180-16-00: A Randomised, Open-Label, Phase III Study of Saruparib (AZD5305) Plus Camizestrant compared with Physician’s Choice CDK4/6 Inhibitor Plus Endocrine Therapy or Plus Camizestrant for the First-Line Treatment of Patients with BRCA1, BRCA2, or PALB2 Mutations and Hormone Receptor-Positive, HER2-Negative (IHC 0, 1+, 2+/ ISH non-amplified) Advanced Breast Cancer (EvoPAR-Breast01).
Protocol code: D9722C00001
Sponsor: AstraZeneca AB (Pharmaceutical company). Phase: Therapeutic confirmatory (Phase III). Countries: Italy (ongoing, recruiting), Germany (ongoing, recruiting), Portugal (ongoing, recruiting), Czechia (ongoing, recruiting), Spain (ongoing, recruiting), Poland (ongoing, recruiting), Austria (ongoing, recruiting), France (ongoing, recruiting), Hungary (ongoing, recruiting), Bulgaria (ongoing, recruiting).
Therapeutic area(s): Diseases [C] - Neoplasms [C04]
Gender: Female, Male. Age: 18-64 years, 65+ years. Enrolment: 136.
Status: Ongoing, recruiting. Start date (EU): 2025-04-07. Decision date: 2024-09-30. Results received: No. Last updated: 2026-07-27.
Decision dates by country: CZ: 2024-10-03, AT: 2024-10-31, FR: 2024-10-07, PL: 2024-10-07, DE: 2024-10-01, HU: 2024-10-04, IT: 2024-10-02, BG: 2024-10-03, PT: 2024-09-30, ES: 2024-10-01

Condition(s): Advanced Breast Cancer
Product: FULVESTRANT, IBRANCE 75 mg film-coated tablets, Saruparib, LETROZOLE, Verzenios 150 mg film-coated tablets, RIBOCICLIB, ANASTROZOLE, IBRANCE 100 mg film-coated tablets, Verzenios 50 mg film-coated tablets, Camizestrant, EXEMESTANE, IBRANCE 125 mg film-coated tablets, Verzenios 100 mg film-coated tablets

Primary endpoint: Progression-Free Survival defined as time from randomisation until progression per RECIST vl.1 as assessed by BICR, or death due to any cause.
Endpoint(s): Overall Survival defined as the time from randomisation until the date of death due to any cause., Progression Free Survival 2 defined as the time from randomisation to the earliest of the progression event (following the initial investigator-assessed progression), after first subsequent therapy, or death., Time to chemotherapy defined as time from randomisation until the start date of the first subsequent chemotherapy treatment after discontinuation of randomised treatment (censoring participants who died prior to initiation of chemotherapy)., Objective Response Rate defined as the proportion of participants who have a complete or partial response, as determined by BICR per RECIST vl.1., Duration of Response defined as the time from the date of first documented response until date of documented progression per RECIST vl.1 as assessed by BICR, or death due to any cause., Participant-reported tolerability defined as proportion of all dosed participants reporting different levels of severity of diarrhoea as measured by the diarrhoea single item (EORTCIL237 /IL239/IL240) and different levels of severity of abdominal pain as measured by the abdominal pain single item (EORTCIL237 /IL239/IL240)., Time to deterioration in patient-reported global health status/QoL as measured by the global health status/QoL scale within the The European Organisation for Research and Treatment of Cancer (EORTC) quality of life questionnaire (QLQ)., Change from baseline in patient-reported global health status/Qol as measured by the global health status/Qol scale within the The European Organisation for Research and Treatment of Cancer (EORTC) quality of life questionnaire (QLQ), Plasma concentrations of saruparib (AZD5305), Plasma concentrations of camizestrant, Samples will be used to develop companion diagnostics by analyzing their performance characteristics and calculate their consistency with clinical trial assays used for enrolment onto the study.

Source: https://euclinicaltrials.eu/ctis-public/view/2023-504180-16-00